EU clinical trial 2024-512062-34-00: The impact of Empagliflozin on Left atrIal Volume and the feasibility of using Fitbit and mHealth to prescribe Exercise in non-diabetic Pre- Heart Failure (ELIVE pre-HF Study)
Sponsor: University College Dublin (Educational Institution). Phase: Therapeutic exploratory (Phase II). Countries: Ireland (ended).
Therapeutic area(s): Diseases [C] - Cardiovascular Diseases [C14]
Gender: Female, Male. Age: 18-64 years, 65+ years. Enrolment: 100.
Status: Ended. Start date (EU): 2023-08-30. End date (EU): 2025-01-16. Decision date: 2024-03-25. Results received: Yes. Last updated: 2024-03-25.

Condition(s): Pre-Heart Failure (Non-diabetic)
Product: Jardiance 10 mg film-coated tablets

Primary endpoint: Change in LAVImax measured by CMR over 6 months
Endpoint(s): Change in CMR LVMI between baseline and 6 months, Change in CMR LVESVi between baseline and 6 months, Change in CMR LVEDVi between baseline and 6 months, Change in CMR LVEF between baseline and 6 months., Change in CMR e’ between baseline and 6 months., Change in CMR LV myocardial strain (measured using feature tracking) between baseline and 6 months., Change in CMR parameter LA myocardial strain (measured using feature tracking) between baseline and 6 months, Change in serum BNP and eGFR from baseline to 6 months

Source: https://euclinicaltrials.eu/ctis-public/view/2024-512062-34-00